EU clinical trial 2025-521224-29-00: An open label, balanced, randomized, two-treatment, two-period, two-sequence, single-dose, crossover, bioequivalence study comparing Lisdexamfetamine Dimesylate capsules 70 mg, manufactured by Sun Pharmaceutical Industries Limited, India with VENVANSE (lisdexamfetamine dimesylate) 70 mg Hard Gelatin Capsule, imported and registered by: Takeda Pharma Ltd. Rodovia SP 340 S/N, km 133.5, Ed. Adm. Jaguariúna-SP CNPJ 60.397.775/0001-74 and manufactured by: Patheon Pharmaceuticals Inc. Cincinnati, United States of America or Takeda Pharma Ltd. Rodovia SP 340 S/N, km 133.5, Ed. QC - Jaguariúna – SP, Brazilian industry in healthy adult, human subjects under fasting condition.
Protocol code: LISDE-01-25
Sponsor: Sun Pharmaceutical Industries Limited (Pharmaceutical company). Phase: Human Pharmacology (Phase I)- Bioequivalence Study. Countries: Romania (ended).
Therapeutic area(s): Psychiatry and Psychology [F] - Mental Disorders [F03]
Gender: Female, Male. Age: 18-64 years. Enrolment: 54.
Status: Ended. Start date (EU): 2026-02-20. End date (EU): 2026-03-24. Decision date: 2025-06-30. Results received: No. Last updated: 2025-06-30.

Condition(s): ADHD (Attention Deficit Hyperactivity Disorder), BED (Binge Eating Disorder)

Source: https://euclinicaltrials.eu/ctis-public/view/2025-521224-29-00